EU clinical trial 2023-510523-30-00: The Methotrexate in ERosive INflammatory Osteoarthritis (MERINO) trial: A randomized placebo-controlled trial to investigate clinical efficacy and safety of methotrexate in erosive inflammatory hand osteoarthritis
Sponsor: Diakonhjemmet Sykehus AS (Hospital/Clinic/Other health care facility). Phase: Therapeutic use (Phase IV). Countries: Norway (ongoing, recruitment ended).
Therapeutic area(s): Diseases [C] - Musculoskeletal Diseases [C05]
Gender: Female, Male. Age: 18-64 years, 65+ years. Enrolment: 163.
Status: Ongoing, recruitment ended. Start date (EU): 2024-02-09. Decision date: 2024-02-09. Results received: No. Last updated: 2025-08-22.

Condition(s): Erosive hand osteoarthritis
Product: Methotrexate Pfizer 2,5 mg tabletter, PLACEBO

Primary endpoint: Difference in self-reported finger joint pain previous 48 hours on a visual analogue scale (VAS; 0-100 mm) at 6 months (M06) of treatment.
Endpoint(s): Fulfillment of Outcome Measures in Rheumatology Osteoarthritis Research Society International (OMERACT-OARSI) responder criteria (all visits)., Self-reported finger pain previous 48 hours on a VAS (0-100 mm) (all visits)., Self-reported thumb pain previous 48 hours on a VAS (0-100 mm) (all visits)., Pain most painful finger joint last 48 hours (VAS) (all visits)., Finger pain and thumb base pain (yes/no) on hand diagram (M00, M06)., Patient-reported disease activity last 48 hours (VAS) (all visits)., Australian/Canadian hand index (AUSCAN) (all visits)., Quality-adjusted life years (QALYs) based on the health-related utility scores measured by the generic instrument EQ-5D (all visits)., Michigan Hand Outcomes Questionnaire (MHOQ) pain and physical function subscales (M00, M06)., Duration of morning stiffness in finger joints (M00, M06), Duration of morning stiffness in thumb base joints (M00, M06), Hospital Anxiety and Depression Scales (HADS) (M00, M06)., Pain Catastrophizing Scale (PCS) (M00, M06)., Pain Sensitivity Questionnaire (PSQ) (M00, M06)., Knee injury and Osteoarthritis Outcome Score (KOOS)-12 (M00, M06)., Hip disability and Osteoarthritis Outcome Score (HOOS)-12 (M00, M06)., Concomitant medication (all visits)., Number of tender and swollen joints (0-30) (all visits)., Grip strength (in kg; using a hand dynamometer) (M00, M06, M12)., Pain sensitization: Pressure Pain Thresholds (PPT) by digital algometer; temporal summation by punctate probes; Conditioned Pain Modulation (CPM) by blood pressure ischemic test (M00, M06)., Ultrasound (screening, all visits): number of finger joints with synovial thickening and power Doppler signals., Conventional radiographs (screening, M06, M12): change in radiographic severity according to: o Kellgren-Lawrence scale o Verbruggen-Veys anatomical phase scoring system o Osteoarthritis Research Society International (OARSI) atlas for the presence/severity of osteophytes, joint space narrowing and erosions, MRI (M00, M06): structural progression and synovitis on static and dynamic contrast-enhanced MRI sequences., Serum or plasma markers of extracellular matrix turnover, including collagens and aggrecan, and markers of inflammation (M00, M06, M12)., Number of adverse events, serious adverse events, and withdrawals because of adverse events (all visits)., Change in synovial cellular composition and gene expression with single-cell RNA sequencing analyses; subgroup analyses, n=16 patients (M00, M06)., Self-reported knee pain previous 48 hours on a VAS (0-100) (M00, M06).

Source: https://euclinicaltrials.eu/ctis-public/view/2023-510523-30-00